EU clinical trial 2024-519994-20-00: CN012-0025: A Phase 3, Open-label Extension Study to Evaluate the Long-term Safety and Tolerability of KarXT + KarX-EC for the Treatment of Agitation Associated with Alzheimer’s Disease (ADAGIO-3)
Protocol code: CN012-0025
Sponsor: Bristol-Myers Squibb Services Unlimited Company (Pharmaceutical company). Phase: Therapeutic confirmatory (Phase III). Countries: Croatia (authorised, recruitment pending), Romania (authorised, recruitment pending), France (authorised, recruitment pending), Spain (ongoing, recruiting), Italy (ongoing, recruiting), Greece (authorised, recruitment pending), Czechia (authorised, recruitment pending), Bulgaria (authorised, recruitment pending), Poland (authorised, recruiting), Portugal (authorised, recruitment pending), Hungary (authorised, recruitment pending).
Therapeutic area(s): Psychiatry and Psychology [F] - Mental Disorders [F03]
Gender: Female, Male. Age: 18-64 years, 65+ years. Enrolment: 193.
Start date (EU): 2026-06-01. Decision date: 2025-10-21. Results received: No. Last updated: 2026-06-24.
Decision dates by country: FR: 2025-10-24, CZ: 2025-10-22, BG: 2025-10-27, IT: 2025-10-22, PT: 2025-10-22, PL: 2025-10-26, ES: 2025-10-27, HU: 2025-10-27, RO: 2025-10-24, GR: 2025-10-21, HR: 2025-10-24

Condition(s): Agitation Associated with Alzheimer’s Disease
Product: KarX-EC, KarXT, KarX-EC, KarX-EC, KarX-EC, KarXT, KarXT, KarXT

Primary endpoint: Incidence of any Treatment-Emergent Adverse Events (TEAEs).
Endpoint(s): Reported adverse events (AEs), TEAEs, serious AEs, and TEAEs leading to study withdrawal and deaths, AEs of special interest, Assessment of abnormal involuntary movements or restlessness, Body weight, Blood pressure and heart rate, Laboratory evaluations, Suicidal ideation, Assessment of cognition, Assessment of urinary retention.

Source: https://euclinicaltrials.eu/ctis-public/view/2024-519994-20-00